EU clinical trial 2024-511465-11-00: Use of statins in patients with intracerebral hemorrhage
Protocol code: SATURN
Sponsor: Fundacio Institut De Recerca De L Hospital De La Santa Creu I Sant Pau (Hospital/Clinic/Other health care facility). Phase: Therapeutic confirmatory (Phase III). Countries: Spain (ongoing, recruiting).
Therapeutic area(s): Diseases [C] - Nervous System Diseases [C10]; Analytical, Diagnostic and Therapeutic Techniques and Equipment [E] - Therapeutics [E02]; Diseases [C] - Pathological Conditions, Signs and Symptoms [C23]
Gender: Female, Male. Age: 18-64 years. Enrolment: 180.
Status: Ongoing, recruiting. Start date (EU): 2024-11-20. Decision date: 2024-11-20. Results received: No. Last updated: 2025-05-12.

Condition(s): Spontaneous lobar ICH
Product: Simvastatina NORMON 10 mg comprimidos recubiertos con película EFG, Atorvastatina NORMON 20 mg comprimidos recubiertos con película EFG, Simvastatina NORMON 40 mg comprimidos recubiertos con película EFG, Atorvastatina NORMON 40 mg comprimidos recubiertos con película EFG, Atorvastatina NORMON 10 mg comprimidos recubiertos con película EFG, Atorvastatina Normon 60 mg comprimidos recubiertos con película, Simvastatina NORMON 20 mg comprimidos recubiertos con película EFG

Primary endpoint: The main efficacy endpoint is the impact of continuing vs. discontinuing statins on the risk of recurrent symptomatic intracerebral hemorrhage (ICH) over a 24-month follow-up period. The safety primary endpoint focuses on the occurrence of major adverse cardiac and cerebrovascular events (MACCE), including ischemic stroke, myocardial infarction, and vascular death
Endpoint(s): Secondary endpoints include quality of life, cognitive and functional outcomes, measured through the EQ-5D questionnaire, modified Rankin Scale (mRS), and Telephone Montreal Cognitive Assessment (T-MoCA). Additionally, the document examines the effects of APOE ε4 and ε2 genotypes on the risk of recurrent ICH

Source: https://euclinicaltrials.eu/ctis-public/view/2024-511465-11-00